EU clinical trial 2024-511171-15-00: Study to evaluate the addition of an experimental drug, CC-90010, to the usual treatment of brain cancer after surgery
Protocol code: CC-90010-GBM-002
Sponsor: Celgene Corp. (Pharmaceutical company). Phase: Human Pharmacology (Phase I)- Other. Countries: Denmark (ended), Sweden (ended), Spain (ended), Italy (ended), Norway (ended), Netherlands (ended).
Therapeutic area(s): Phenomena and Processes [G] - Metabolism [G03]
Gender: Female, Male. Age: 18-64 years, 65+ years. Enrolment: 216.
Status: Ended. Start date (EU): 2020-07-06. End date (EU): 2024-04-18. End date: 2024-07-10. Decision date: 2024-04-03. Results received: No. Last updated: 2024-07-04.
Decision dates by country: NO: 2024-04-03, SE: 2024-05-09, DK: 2024-04-03, ES: 2024-05-09, NL: 2024-05-09, IT: 2024-05-09

Condition(s): Subjects with newly diagnosed WHO Grade IV glioblastoma (ndGBM) who have undergone complete or partial tumor resection

Source: https://euclinicaltrials.eu/ctis-public/view/2024-511171-15-00